EU clinical trial 2025-524514-28-00: A Multicenter, Randomized, Double-Blind, Placebo-Controlled Dose-Finding Study of CX11 Tablets in Patients with Type 2 Diabetes Mellitus.
Protocol code: CX11202
Sponsor: Corxel Pharmaceuticals Inc. (Pharmaceutical company). Phase: Therapeutic exploratory (Phase II). Countries: Poland (ongoing, recruiting).
Therapeutic area(s): Diseases [C] - Nutritional and Metabolic Diseases [C18]
Gender: Female, Male. Age: 18-64 years, 65+ years. Enrolment: 121.
Status: Ongoing, recruiting. Start date (EU): 2026-05-06. Decision date: 2026-04-22. Results received: No. Last updated: 2026-05-29.

Condition(s): Type 2 Diabetes Mellitus
Product: CX11, Placebo to cx11 80 mg, CX11, Placebo to cx11 40 mg

Primary endpoint: Change in HbA1c from baseline
Endpoint(s): 1. HbA1c < 7.0% 2. HbA1c ≤ 6.5% 3. Change of TIR on CGM from baseline 4. Change in FPG from baseline 5. Change in body weight from baseline 6. Percent change in body weight from baseline 7. Body weight loss ≥ 5% 8. Body weight loss ≥ 10% 8. Body weight loss ≥ 10%, 9. Change in SBP and DBP from baseline 10. Number of level 2 hypoglycemic episodes or severe hypoglycemic episodes 11. TEAE & AESI; 12. Population PK parameters

Source: https://euclinicaltrials.eu/ctis-public/view/2025-524514-28-00